EU clinical trial 2022-503047-17-00: A phase I, open-label trial in two parallel parts to investigate mass balance, metabolism, and basic pharmacokinetics of BI 1810631 (C-14) administered as oral solution (part A) and to investigate absolute bioavailability of BI 1810631 administered as film-coated tablet together with an intravenous microtracer dose of BI 1810631 (C-14) (part B) in healthy male volunteers
Protocol code: 1479-0006
Sponsor: Boehringer Ingelheim International GmbH (Pharmaceutical company). Phase: Human Pharmacology (Phase I)- Other. Countries: Netherlands (ended).
Therapeutic area(s): Not possible to specify
Gender: Male. Age: 18-64 years. Enrolment: 15.
Status: Ended. Start date (EU): 2023-08-10. End date (EU): 2023-10-19. Decision date: 2023-07-17. Results received: Yes. Last updated: 2023-07-17.

Condition(s): Healthy
Product: BI 1810631 (C-14), BI 1810631 (C-14)

Primary endpoint: Part A – Primary endpoints will be the mass balance and total recovery of [14C]-radioactivity in urine and faeces: • feurine, 0-tz (fraction excreted in urine as percentage of the administered dose over the time interval from 0 to the last quantifiable time point) • fefaeces, 0-tz (fraction excreted in faeces as percentage of the administered dose over the time interval from 0 to the last quantifiable time point), Part B – The following primary endpoint will be determined in plasma for [14C]BI 1810631 after intravenous administration and for BI 1810631 after oral administration: • AUC0-∞ (area under the concentration-time curve of the analyte over the time interval from 0 extrapolated to infinity)
Endpoint(s): Part A – for BI 1810631 and for [14C]-radioactivity (assessed by [14C]BI 1810631-EQ) in plasma: • Cmax (maximum measured concentration of the analyte) • AUC0-tz (area under the concentration-time curve of the analyte over the time interval from 0 to the last quantifiable time point), Part B – for [14C]BI 1810631 after intravenous administration and for BI 1810631 after oral administration: • Cmax • AUC0-tz (area under the concentration-time curve of the analyte over the time interval from 0 to the last quantifiable time point)

Source: https://euclinicaltrials.eu/ctis-public/view/2022-503047-17-00